EU clinical trial 2023-510557-42-00: HOVON 141 CLL: A prospective, multicenter, phase-II trial of ibrutinib plus venetoclax in patients with creatinine clearance ≥ 30 ml/min who have relapsed or refractory chronic lymphocytic leukemia (RR-CLL) with or without TP53 aberrations.
Protocol code: HO141
Sponsor: Hemato-Oncologie voor Volwassenen Nederland (Hovon) Stichting (Hospital/Clinic/Other health care facility). Phase: Therapeutic exploratory (Phase II). Countries: Sweden (ended), Netherlands (ended), Belgium (ended), Norway (ended), Finland (ended), Denmark (ended).
Therapeutic area(s): Diseases [C] - Neoplasms [C04]; Diseases [C] - Hemic and Lymphatic Diseases [C15]
Gender: Female, Male. Age: 18-64 years, 65+ years. Enrolment: 230.
Status: Ended. Start date (EU): 2017-07-10. End date (EU): 2025-12-17. Decision date: 2024-07-03. Results received: No. Last updated: 2026-04-13.
Decision dates by country: BE: 2024-07-11, NL: 2024-07-03, DK: 2024-07-04, FI: 2024-07-04, NO: 2024-07-16, SE: 2024-07-04

Condition(s): chronic lymphocytic leukemia
Product: Venclyxto 10 mg film-coated tablets, Venclyxto 100 mg film-coated tablets, IMBRUVICA 140 mg hard capsules, Venclyxto 50 mg film-coated tablets

Primary endpoint: Proportion of patients fulfilling the criteria for progression free survival (PFS) at 12 months after stopping therapy for patients randomized to stop treatment. In this trial, reinitiated treatment due to MRD positivity will not be considered as progression, and symptomatic CLL according to IWCLL criteria within 12 months after randomization followed by reinitiation treatment resulting in a response before or at 12 months after randomization will neither be considered as progression
Endpoint(s): Minimal residual disease (MRD) at 12 months after stopping treatment (month 27) for patients randomized to stop of treatment, PFS of all study groups, Time to and number of patients reinitiating treatment, Time to treatment failure after reinitiated treatment, Time to next CLL treatment, MRD after cycle 12 (PB), at day 15 of cycle 15 (PB and BM) and at later time points in PB, Overall survival (OS), Complete response (CR)/ Partial Response (PR)/ Stable disease (SD) after cycle 3, 9, 12, 15 and month 27 and month 51 (3 years after stopping treatment), Duration of response, Safety parameters: Type, frequency, and severity of adverse events (AEs) and adverse events of special interest (AESI) and their relationship to study treatment, Health-related quality of life (QoL) by EORTC QLQ-C30 and QLQ-CLL16 questionnaires, Exploratory endpoint: Evaluation of relationship between various baseline markers and clinical outcome parameters, Exploratory endpoint: Various markers at time of progression, Exploratory endpoint: Correlation between MRD in BM and PB, Exploratory endpoint: Correlation between MRD in BM and PFS/OS, Exploratory endpoint: Correlation between MRD in PB and PFS/OS

Source: https://euclinicaltrials.eu/ctis-public/view/2023-510557-42-00